EU clinical trial 2024-513978-22-00: A Phase 3 Study to Evaluate the Safety and Efficacy of a Single Dose of CTX001 in Pediatric Subjects With Severe Sickle Cell Disease
Protocol code: VX21-CTX001-151
Sponsor: Vertex Pharmaceuticals Inc. (Pharmaceutical company). Phase: Therapeutic confirmatory (Phase III). Countries: Italy (ongoing, recruiting), Germany (ongoing, recruiting).
Therapeutic area(s): Diseases [C] - Congenital, Hereditary, and Neonatal Diseases and Abnormalities [C16]
Gender: Female, Male. Age: 0-17 years. Enrolment: 4.
Status: Ongoing, recruiting. Start date (EU): 2022-07-20. Decision date: 2024-11-22. Results received: No. Last updated: 2026-06-16.
Decision dates by country: DE: 2024-11-22, IT: 2025-01-14

Condition(s): Severe sickle cell disease (SCD)
Product: PLERIXAFOR, BUSULFAN, Casgevy 4 - 13 x 10^6 cells/mL dispersion for infusion

Primary endpoint: Proportion of subjects who do not have any severe vaso-occlusive crises (VOCs) for at least 12 consecutive months (VF12) after CTX001 infusion. The evaluation of VF12 starts 60 days after the last red blood cell (RBC) transfusion for post- transplant support or SCD disease management.
Endpoint(s): Safety and tolerability of CTX001 based on adverse events (AEs), clinical laboratory values, vital signs, neutrophil engraftment, platelet engraftment, transplant-related mortality (TRM), and all-cause mortality., Proportion of subjects free from inpatient hospitalization for severe VOCs for at least 12 months (HF12) after CTX001 infusion. The evaluation of HF12 starts 60 days after last RBC transfusion for post-transplant support or SCD disease management., Relative reduction from baseline in annualized rate of severe VOCs up to 24 months after CTX001 infusion. The evaluation starts 60 days after last RBC transfusion for post-transplant support or SCD disease management, Duration of severe VOC free in subjects who have achieved VF12., Relative reduction from baseline in annualized rate of inpatient hospitalizations for severe VOCs up to 24 months after CTX001 infusion. The evaluation starts 60 days after last RBC transfusion for post-transplant support or SCD disease management., Relative reduction from baseline in annualized duration of hospitalization for severe VOCs up to 24 months after CTX001 infusion. The evaluation starts 60 days after last RBC transfusion for post-transplant support or SCD disease management., Proportion of subjects with sustained fetal hemoglobin (HbF) ≥20% at the time of analysis for at least 3 months, 6 months, or 12 months. The evaluation starts 60 days after last RBC transfusion for post-transplant support or SCD disease management, Proportion of subjects with sustained HbF ≥30% at the time of analysis for at least 3 months, 6 months, or 12 months. The evaluation starts 60 days after last RBC transfusion for post-transplant support or SCD disease management, Time for subjects to reach HbF ≥20%, Time for subjects to reach HbF ≥30%, Relative reduction from baseline in annualized volume and episodes of RBC transfusions, HbF concentrations over time, Hemoglobin (Hb) concentrations over time, Change from baseline in reticulocyte count (percent reticulocytes and absolute reticulocyte count) over time, Change from baseline in indirect bilirubin over time, Change from baseline in haptoglobin over time, Proportion of subjects with detectable haptoglobin over time, Change from baseline in lactate dehydrogenase (LDH) over time, Proportion of subjects with normalized LDH over time, Proportion of alleles with intended genetic modification present in peripheral blood over time, Proportion of alleles with intended genetic modification present in CD34+ cells of the bone marrow over time

Source: https://euclinicaltrials.eu/ctis-public/view/2024-513978-22-00